EU clinical trial 2023-505946-24-00: Long-term Safety and Tolerability of TAK-881 in Subjects with Primary Immunodeficiency Diseases (PIDD)
Protocol code: TAK-881-3002
Sponsor: Takeda Development Center Americas Inc., Baxalta Innovations GmbH (Pharmaceutical company). Phase: Therapeutic confirmatory (Phase III). Countries: Greece (ended), Germany (ended), Poland (ongoing, recruiting), Netherlands (ended), Denmark (ongoing, recruitment ended), Czechia (ongoing, recruiting), Spain (ongoing, recruiting), Slovakia (ongoing, recruiting).
Therapeutic area(s): Diseases [C] - Immune System Diseases [C20]
Gender: Female, Male. Age: 0-17 years, 18-64 years, 65+ years. Enrolment: 17.
Start date (EU): 2025-05-15. Decision date: 2024-03-11. Results received: No. Last updated: 2026-05-04.
Decision dates by country: DE: 2024-03-12, NL: 2024-03-15, DK: 2024-03-12, GR: 2024-03-14, PL: 2024-03-15, SK: 2024-03-11, ES: 2024-03-11, CZ: 2024-03-13

Condition(s): Primary Immunodeficiency Diseases
Product: TAK-881

Primary endpoint: Occurrence of TEAEs., Occurrence of infusion withdrawals, interruptions, and infusion rate reductions due to TAK-881-related TEAEs.
Endpoint(s): Efficacy • Annualized rate of all infections. • Annualized rate of ASBIs. • Annualized rate of episodes of fever. • Time to first ASBI. • Duration of infections., Immunogenicity • Occurrence of positive binding (defined as titer ≥1:160) and neutralizing antibodies to rHuPH20., Pharmacokinetics • Trough level of total IgG., Treatment regimen • Dose of TAK-881. • Treatment interval of TAK-881., Infusion parameters: • Number of infusions per month. • Number of infusion sites (needle sticks) per month. • Number of infusion sites (needle sticks) per infusion. • Duration of infusions (minutes). • Monthly infusion time (minutes/month). • Maximum tolerated infusion rate per site (mL/hour/site). • Infusion volume per site (mL/site). • Physical location of infusion (site/infusion center or home). • Subject, caregiver, or healthcare professional (HCP) administration of IP., Subject satisfaction • Subject satisfaction evaluated by subject-reported scores on the Treatment Satisfaction Questionnaire for Medication (TSQM) - 9 items (TSQM-9)., Health-related quality of life • Subject HRQoL evaluated via EQ-5D-5L., Treatment preferences • Treatment preferences measured by a disease-specific questionnaire., Healthcare resource utilization • Days not able to go to school, work, daycare or to perform normal daily activities due to infections and/or their treatment or other illnesses. • Days on antibiotics. • Number of hospitalizations, indication for the hospitalization (infection or other illnesses) and days hospitalized. • Number of acute physician visits due to infection or other illnesses., Infusion preparation • HCP-measured time of infusion preparation per guidelines in the Pharmacy Manual/Site Infusion Manual. • Subject/caregiver measured time of infusion preparation per guidelines in the Subject Infusion Manual.

Source: https://euclinicaltrials.eu/ctis-public/view/2023-505946-24-00